EU clinical trial 2022-502267-37-00: Z0011001-A PHASE 1/2, OPEN-LABEL, MULTI-CENTER STUDY OF ZN-c3 ADMINISTERED IN COMBINATION WITH ENCORAFENIB AND CETUXIMAB IN ADULTS WITH METASTATIC COLORECTAL CANCER
Protocol code: Z0011001 (ZN-c3-016)
Sponsor: K-Group Beta Inc. (Pharmaceutical company). Phase: Phase I and Phase II (Integrated)- Other. Countries: Poland (ended), Spain (ended), Germany (ended), Hungary (ended), Italy (ended).
Therapeutic area(s): Diseases [C] - Neoplasms [C04]
Gender: Female, Male. Age: 18-64 years. Enrolment: 50.
Status: Ended. Start date (EU): 2023-07-17. End date (EU): 2025-11-24. End date: 2025-11-25. Decision date: 2023-06-16. Results received: Yes. Last updated: 2025-06-03.
Decision dates by country: DE: 2023-06-20, HU: 2023-06-20, IT: 2023-06-21, ES: 2023-06-16, PL: 2023-06-21

Condition(s): metastatic colorectal cancer
Product: Azenosertib (also known as ZN-c3; KP-2638), ENCORAFENIB, CETUXIMAB, Azenosertib (also known as ZN-c3; KP-2638)

Primary endpoint: Dose escalation: Incidence of DLTs (dose-limiting toxicities)., Expansion cohort: ORR by Investigator, defined as the proportion of participants who have achieved a confirmed BOR of CR or PR per RECIST version 1.1.
Endpoint(s): Escalation: Incidence and severity of AEs graded according to the NCI CTCAE v5.0 and changes in clinical laboratory parameters, vital signs and ECGs. Incidence of dose interruptions, dose modifications and discontinuations due to AEs., Escalation: ORR, DOR, PFS, DCR and TTR by Investigator., Escalation: Plasma PK parameters of ZN-c3 (and its potential metabolites as applicable), including but not limited to Cmax, Tmax, and AUC., Escalation: Plasma PK parameters of encorafenib including but not limited to Cmax, Tmax, and AUC., Expansion: DOR, PFS, DCR and TTR by Investigator., Expansion: Incidence and severity of AEs graded according to the NCI CTCAE v5.0 and changes in clinical laboratory parameters, vital signs and ECGs. Incidence of dosing interruptions, dose modifications and discontinuations associated with AEs., Expansion: Plasma PK parameters of ZN-c3 (and its potential metabolites as applicable), including but not limited to Cmax, Tmax, and AUC., Expansion: Plasma PK parameters of encorafenib including but not limited to Cmax, Tmax, and AUC., Expansion: Plasma PK parameters of ZN-c3 including but not limited to Cmax and AUC., Expansion: BRAF V600E mutational status.

Source: https://euclinicaltrials.eu/ctis-public/view/2022-502267-37-00